EU clinical trial 2023-503235-18-00: An Open Label, Multicenter Phase 2 Study to Evaluate the Efficacy and Safety of the BCL2 Inhibitor Sonrotoclax (BGB 11417) as Monotherapy and in Combination with Zanubrutinib (BGB-3111) in Patients With Waldenström Macroglobulinemia
Protocol code: BGB-11417-203
Sponsor: BeOne Medicines AG (Pharmaceutical company). Phase: Therapeutic exploratory (Phase II). Countries: Spain (ongoing, recruitment ended), France (ongoing, recruitment ended), Greece (ongoing, recruitment ended), Italy (ongoing, recruitment ended).
Therapeutic area(s): Diseases [C] - Hemic and Lymphatic Diseases [C15]
Gender: Female, Male. Age: 18-64 years, 65+ years. Enrolment: 64.
Status: Ongoing, recruitment ended. Start date (EU): 2024-01-31. Decision date: 2023-12-15. Results received: No. Last updated: 2026-04-13.
Decision dates by country: FR: 2023-12-21, IT: 2023-12-19, ES: 2023-12-15, GR: 2023-12-22

Condition(s): previously untreated WM, Relapsed/Refractory Waldenström’s Macroglobulinemia
Product: Zanubrutinib, BGB-11417, BGB-11417

Primary endpoint: Major response rate (MRR, defined as the proportion of patients achieving partial response [PR] or better per the 11th International Workshop on Waldenström Macroglobulinemia (IWWM) (hereafter as IWWM-11 WM response criteria) as assessed by the Independent Review Committee (Cohort 1)
Endpoint(s): MRR as assessed by the IRC in Cohorts 2 and 3 and by the investigator in Cohorts 1 to 4, Duration of major response (DoMR) as assessed by the IRC in Cohort 1 to 3 and by the investigator in Cohorts 1 to 4, Complete response (CR) + very good partial response (VGPR) rate as assessed by the IRC in Cohorts 1 to 3 and by the investigator in Cohorts 1 to 4, Overall response rate (ORR, defined as the proportion of patients achieving minor response [MR] or better) as assessed by the IRC in Cohorts 1 to 3 and by the investigator in Cohorts 1 to 4, Progression free survival (PFS) as assessed by the IRC and investigator in Cohorts 1 to 3, Time to major response as assessed by the IRC in Cohorts 1 to 3 and by the investigator in Cohorts 1 to 4, Overall survival (OS) in Cohorts 1 to 3, The frequency and severity of adverse events, serious adverse events, and laboratory abnormalities according to National Cancer Institute Common Terminology for Adverse Event (NCI CTCAE v5.0), Health-related quality of life (HRQoL) based on patient reported outcomes (PRO) using National Comprehensive Cancer Network/Functional Assessment of Cancer Therapy Lymphoma Cancer Symptom Index 18 Item (NFLymSI-18) Version 4, Duration of response (DOR) as assessed by the IRC in Cohorts 1 to 3 and by the investigator in Cohorts 1 to 4, Time to next treatment in Cohort 4

Source: https://euclinicaltrials.eu/ctis-public/view/2023-503235-18-00